EU clinical trial 2024-518684-35-00: Biomarker-guided treatment-and-stop-strategy for recombinant IL-1receptor antagonist (anakinra) in patients with systemic Juvenile Idiopathic Arthritis
Protocol code: NL55231.041.16
Sponsor: Universitair Medisch Centrum Utrecht (Hospital/Clinic/Other health care facility). Phase: Therapeutic use (Phase IV). Countries: Netherlands (authorised, recruitment pending).
Therapeutic area(s): Diseases [C] - Musculoskeletal Diseases [C05]; Diseases [C] - Immune System Diseases [C20]
Gender: Female, Male. Age: 0-17 years. Enrolment: 68.
Status: Authorised, recruitment pending. Decision date: 2024-12-13. Results received: No. Last updated: 2024-12-13.

Condition(s): autoimmune disorders, joint disorders synonym: Still's disease, systemic JIA
Product: Kineret 100 mg/0.67 ml solution for injection in pre-filled syringe.

Primary endpoint: * The total (mean/median) number of injections of anakinra per patient necessary to achieve and maintain clinically inactive disease during the first year of treatment.
Endpoint(s): * The number of patients with *clinically inactive disease* without medication at time point 1 year., * The total number of disease flares during or after tapering and stop of therapy in the first year;, * The number of patients with remission off medication at time point 2 years;, * The number of patients needing to switch treatment because of treatment failure during the first year (to calculate reduction in treatment costs), * The number of (serious) adverse events in the first year.

Source: https://euclinicaltrials.eu/ctis-public/view/2024-518684-35-00